EU clinical trial 2024-513792-41-00: Hepatitis B immunoglobulins to induce HBsAg clearance in patients with chronic hepatitis B (HBIG for cure)
Protocol code: HBIG for cure
Sponsor: Medizinische Hochschule Hannover (Educational Institution). Phase: Therapeutic exploratory (Phase II). Countries: Germany (ended).
Therapeutic area(s): Diseases [C] - Virus Diseases [C02]
Gender: Female, Male. Age: 18-64 years, 65+ years. Enrolment: 20.
Status: Ended. Start date (EU): 2022-08-15. End date (EU): 2025-07-31. Decision date: 2024-11-01. Results received: Yes. Last updated: 2024-11-01.

Condition(s): Chronic hepatitis B
Product: Hepatect CP 50 I.E./ml Infusionslösung, Zutectra 500 IU solution for injection in pre-filled syringe

Primary endpoint: HBsAg negativity at week 12 of antiviral therapy
Endpoint(s): HBsAg decline at weeks 1, 2, 4, 8 and 12 of treatment, post-treatment HBsAg negativity up to FU week 24, HBV DNA levels during and after hepatitis B immunoglobulin treatment will be reported for each cohort, biochemical response (proportion of subjects who reached ALT normalization (ALT ≤ ULN) at week 12 of treatment), quality of life during treatment and follow-up (SF-36)

Source: https://euclinicaltrials.eu/ctis-public/view/2024-513792-41-00